EU clinical trial 2023-507173-18-00: A Randomized, Double-Blind (Sponsor Unblinded), Placebo-Controlled, Study to Investigate the Antiviral Effect, Safety, Tolerability and Pharmacokinetics of VH4524184 in HIV-1 Infected Treatment Naïve Adults
Protocol code: 218806
Sponsor: Viiv Healthcare UK Limited (Pharmaceutical company). Phase: Therapeutic exploratory (Phase II). Countries: Spain (ended), Italy (ended).
Therapeutic area(s): Diseases [C] - Virus Diseases [C02]
Gender: Female, Male. Age: 18-64 years, 65+ years. Enrolment: 11.
Status: Ended. Start date (EU): 2024-04-09. End date (EU): 2024-07-11. End date: 2024-07-12. Decision date: 2024-04-01. Results received: Yes. Last updated: 2024-07-19.
Decision dates by country: IT: 2024-04-02, ES: 2024-04-01

Condition(s): HIV Infections
Product: Visual match to product

Primary endpoint: Maximum Change from Baseline in logarithm in 10 base (log10) Plasma HIV-1 Ribonucleic Acid (RNA) Through Day 10
Endpoint(s): Number of Participants with Adverse Events (AEs), Number of Participants with AEs by severity, Number of Participants with AEs Leading to Study Treatment Discontinuation, Change from Baseline for Liver Panel Laboratory Parameters: Alanine Aminotransferase (ALT), Aspartate Aminotransferase (AST), Alkaline Phosphatase (ASP) (International units per liter), Change from Baseline for Liver Panel Laboratory Parameters: Total bilirubin, Direct bilirubin (Micromoles per liter [umol/L]), Change from Baseline for Liver Panel Laboratory Parameters: Albumin and Total Protein (Grams per liter [g/L]), Percentage of Participants with Maximum Toxicity Grade Increase Relative to Baseline in liver panel laboratory parameters: ALT, AST, total bilirubin, direct bilirubin, alkaline phosphatase, albumin and total protein, Maximum Observed Plasma Drug Concentration (Cmax) of VH4524184, Time to Maximum Observed Plasma Drugs Concentration (tmax) of VH4524184, Plasma Concentration of VH4524184 on Day 10, Correlation of VH4524184 PK Parameters with Maximum Plasma HIV-1 RNA change from baseline through Day 10, Number of Participants with Treatment-emergent Genotypic Resistance, Number of Participants with Treatment-emergent Phenotypic Resistance, Change From Baseline in Cluster of Differentiation 4 (CD4+) T-cell Counts at Day 10

Source: https://euclinicaltrials.eu/ctis-public/view/2023-507173-18-00